EU clinical trial 2025-522136-14-00: Antibiotic Treatment Trial in Acute Coronary Syndrome
Sponsor: TAYS Sydaenkeskus Oy (Hospital/Clinic/Other health care facility). Phase: Phase III and phase IV (Integrated). Countries: Finland (authorised, recruitment pending).
Therapeutic area(s): Diseases [C] - Cardiovascular Diseases [C14]
Gender: Female, Male. Age: 18-64 years, 65+ years. Enrolment: 1070.
Status: Authorised, recruitment pending. Decision date: 2025-08-27. Results received: No. Last updated: 2025-08-27.

Condition(s): non-ST-elevation myocardial infarction (NSTEMI), ST-elevation myocardial infarction (STEMI), coronary artery disease
Product: Ceftriaxon Navamedic 2 g infuusiokuiva-aine, liuosta varten, Amoxin 500 mg kalvopäällysteinen tabletti

Primary endpoint: Major adverse cardiac and cerebrovascular events (MACCE) in 12 months follow-up, including: cardiovascular death, myocardial infarction, hospitalization for NYHA IV heart failure, stroke or transient ischemic attack (TIA)
Endpoint(s): Individual components of the primary end point at 12 months, MACCE at 3 months, MACCE at 2 and 5 years

Source: https://euclinicaltrials.eu/ctis-public/view/2025-522136-14-00